EU clinical trial 2023-506890-37-00: Phase 1 Study of AZD9833 Alone or in Combination in Women with Advanced Breast Cancer
Protocol code: D8530C00001
Sponsor: Astrazeneca AB (Pharmaceutical company). Phase: Human Pharmacology (Phase I)- First administration to humans. Countries: Spain (ongoing, recruitment ended).
Therapeutic area(s): Diseases [C] - Neoplasms [C04]
Gender: Female. Age: 18-64 years, 65+ years. Enrolment: 173.
Status: Ongoing, recruitment ended. Start date (EU): 2019-03-01. Decision date: 2024-04-29. Results received: No. Last updated: 2026-07-22.

Condition(s): "Estrogen Receptor Positive HER2 Negative Advanced Breast Cancer"

Source: https://euclinicaltrials.eu/ctis-public/view/2023-506890-37-00